EU clinical trial 2025-522784-15-00: A Phase 2 Double-blind, Randomised, Placebo-controlled Study to Evaluate the Efficacy, Safety, Pharmacokinetics, and Pharmacodynamics of DT-101 in Adults with Major Depressive Disorder
Protocol code: DT-101/201
Sponsor: Draig Therapeutics Limited (Pharmaceutical company). Phase: Therapeutic exploratory (Phase II). Countries: Czechia (ongoing, recruiting), Bulgaria (ongoing, recruiting), Poland (authorised, recruiting).
Therapeutic area(s): Psychiatry and Psychology [F] - Mental Disorders [F03]
Gender: Female, Male. Age: 18-64 years, 65+ years. Enrolment: 113.
Start date (EU): 2026-03-24. Decision date: 2026-02-24. Results received: No. Last updated: 2026-07-06.
Decision dates by country: BG: 2026-02-26, PL: 2026-02-26, CZ: 2026-02-24

Condition(s): Major Depressive Disorder
Product: DT-101, Matching placebo capsule for PO administration, DT-101

Primary endpoint: This will be assessed by reviewing the change in the participants score of the depression rating scale called Montgomery Åsberg Depression Rating Scale (MADRS)

Source: https://euclinicaltrials.eu/ctis-public/view/2025-522784-15-00